EU clinical trial 2024-519133-29-00: Efficacy of probenecid on cluster seizures during dosage reduction of Anti Seizure Medication (ASM) in presurgical focal epilepsy video-EEG monitoring
Protocol code: GHD_2024_12
Sponsor: Fondation A De Rothschild (Hospital/Clinic/Other health care facility). Phase: Therapeutic exploratory (Phase II). Countries: France (authorised, recruitment pending).
Therapeutic area(s): Diseases [C] - Nervous System Diseases [C10]
Gender: Female, Male. Age: 0-17 years, 18-64 years. Enrolment: 192.
Status: Authorised, recruitment pending. Decision date: 2025-10-17. Results received: No. Last updated: 2026-05-19.

Condition(s): Focal epilepsy
Product: placebo, SANTURIL 500 mg comprimé sécable

Primary endpoint: Proportion of patients without seizure between 60 min and 12h after PBN or placebo administration, assessed by the neurologist on video and EEG recording, in patients experiencing SC defined as at least 2 epileptic seizures lasting less than 10 min occurring in 6 hours or less during presurgical hospital videoEEG monitoring for focal epilepsy
Endpoint(s): Introduction of benzodiazepines or increase in weaned antiepileptic medication (if weaned) within 12 hours of treatment administration, Time spent in seizure in minutes, assessed by the blinded neurologist on video and EEG recording, Occurrence of tonic-clonic generalized seizure, assessed by the blinded neurologist on video and EEG recording, Occurrence of a status epilepticus, assessed by the blinded neurologist on video and EEG recording, Seizure-related injury (bone or tooth fracture, hematoma) assessed by the blinded neurologist, Interictal activity quantified by the blinded neurologist on video and EEG recording as the evolution of the number of interictal spikes recorded during 15 minutes, 2 hours after treatment administration compared to the same period the day before, Number of seizures during the rest of video EEG monitoring, assessed by the blinded neurologist on video and EEG recording, Evolution of heart rate and blood pressure measurements from treatment administration to 2 hours post-administration, Adverse and serious adverse events

Source: https://euclinicaltrials.eu/ctis-public/view/2024-519133-29-00